EU clinical trial 2024-519985-35-00: Obinutuzumab for systemic lupus erythematosus pure membranous nephropathy: a phase II trial (OBLUMEN)
Protocol code: APHP240937
Sponsor: Assistance Publique Hopitaux De Paris (Hospital/Clinic/Other health care facility). Phase: Therapeutic exploratory (Phase II). Countries: France (authorised, recruitment pending).
Therapeutic area(s): Diseases [C] - Pathological Conditions, Signs and Symptoms [C23]
Gender: Female, Male. Age: 18-64 years, 65+ years. Enrolment: 65.
Status: Authorised, recruitment pending. Decision date: 2026-07-15. Results received: No. Last updated: 2026-07-15.

Condition(s): systemic lupus erythematosus pure membranous nephropathy
Product: Gazyvaro 1,000 mg concentrate for solution for infusion.

Primary endpoint: At W52 after the first obinutuzumab infusion : Complete Renal Response (CRR) AND No intercurrent event
Endpoint(s): To quantify adverse events, serious adverse events, and adverse events of special interest (neutropenia, new cancer, infusion related events, infections) between the first obinutuzumab infusion and W52., To quantify the proportion of patient with no-kidney response (NKR), partial renal response (PRR), complete renal response (CRR) and renal relapses without any intercurrent event during follow-up at W52., To quantify the proportion of patients reaching immunologic remission (normalization C3 and C4 levels and negativation of anti-dsDNA) and the number of renal and extrarenal flares during follow-up at W52., To assess the proportion of patients that are free from corticosteroids at W52, To assess the quality of life of patients at W52

Source: https://euclinicaltrials.eu/ctis-public/view/2024-519985-35-00